EU clinical trial 2022-501187-18-00: A Randomized, Open-label, Phase 3 Study of Acalabrutinib in Combination with Rituximab and Reduced Dose CHOP (R-miniCHOP) in Older Adults with Untreated Diffuse Large B-Cell Lymphoma (ARCHED/GLA 2022-1)
Protocol code: ARCHED/GLA 2022-1
Sponsor: University Of Saarland. Phase: Therapeutic confirmatory (Phase III). Countries: Germany (ongoing, recruiting), Greece (ongoing, recruiting).
Therapeutic area(s): Diseases [C] - Hemic and Lymphatic Diseases [C15]; Diseases [C] - Neoplasms [C04]
Gender: Female, Male. Age: 18-64 years, 65+ years. Enrolment: 360.
Status: Ongoing, recruiting. Start date (EU): 2023-04-24. Decision date: 2023-04-03. Results received: No. Last updated: 2026-07-16.
Decision dates by country: GR: 2025-07-07, DE: 2023-04-03

Condition(s): a. Diffuse large B-cell lymphoma (DLBCL) not otherwise specified (NOS), b. Primary cutaneous DLBCL leg type, c. Intravascular large B-cell lymphoma, d. EBV+ DLBCL NOS, e. HHV8+DLBCL NOS, f. primary mediastinal (thymic) large B-cell lymphoma, g. B-cell lymphoma, with intermediate features between DLBCL and classical Hodgkin lymphoma, h. follicular lymphoma grade 3B, i. high-grade B-cell lymphoma NOS, j. high-grade B-cell lymphoma, with MYC and BCL2 and/or BCL6 rearrangements, k. T-cell/histiocyte-rich large B-cell lymphoma, l. DLBCL associated with chronic inflammation, m. ALK+ large B-cell lymphoma, n. large B-cell lymphoma with IRF4 rearrangement
Product: PREDNISONE, Calquence 100 mg film-coated tablets, PREDNISOLONE, PEGFILGRASTIM, Calquence 100 mg hard capsules, VINCRISTINE SULFATE, RITUXIMAB, RITUXIMAB, CYCLOPHOSPHAMIDE, DOXORUBICIN

Primary endpoint: PFS, defined by the time between the day of randomization until one of the following events occurs, whichever comes first: Disease progression (PD), relapse after complete remission (CR) or death due to any cause, as per Lugano Classification of 2014. Patients who have not experienced an event at the time of analysis will be censored at the most recent date of adequate disease assessment (for definition see 10.6.1)..
Endpoint(s): OS, defined by the time between the day of randomization until death due to any cause. Patients who have not experienced an event at the time of analysis will be censored at the date when the patient was last known to be alive., PFS, as defined above, based on blinded independent central review (BICR)., EFS, defined by the time between the day of randomization until one of the following events occurs, whichever comes first: Progressive disease (PD), relapse after complete remission (CR), initiation of subsequent systemic anti-lymphoma treatment and/or irradiation or death due to any cause, as per Lugano Classification of 2014. Patients who have not experienced an event at the time of analysis will be censored at the most recent date of adequate disease assessment., PFS, OS and EFS, as defined above, according to cell of origin (COO) as per immunohistochemistry and gene expression analysis, PFS, OS and EFS, as defined above according to DLBCL molecular genotype., PFS, OS and EFS, as defined above, according to age groups (>60 - 80 years vs >80 years) and according to gender and serum albumin., Rate of (metabolic) CR, defined as the number of patients achieving CR as best overall response after end of study treatment divided by the number of randomized patients., Rate of PR, defined as the number of partial remissions after end of study treatment divided by the number of randomized patients., Overall response rate (ORR), defined as the number of complete and partial remissions after end of study treatment, divided by the number of randomized patients., Duration of response (DoR), defined as the time from documentation of tumor response to disease progression or relapse, or death of any cause., Progression rate, defined as the number of progressions after end of study treatment divided by the number of randomized patients., Relapse rate, defined as the number of relapses divided by the number of patients with complete remission after end of study treatment., CNS relapse rate, defined as the cumulative CNS incidence rate., AEs, SAEs, adverse events of special interest (AESIs), events of clinical interest, AEs leading to study treatment discontinuation or dose modification. Rate of secondary malignancies, defined as the number of patients with secondary malignancies divided by the number of randomized patients., Treatment-related death rate, defined as the number of treatment related deaths during therapy or up to 2 months after the end of study treatment, but before the start of further treatment, divided by the number of randomized patients., Number and duration of therapy cycles, cumulative and relative doses of miniCHOP, rituximab and acalabrutinib.

Source: https://euclinicaltrials.eu/ctis-public/view/2022-501187-18-00